EU clinical trial 2023-508571-37-00: A Phase 2, Double-Masked, Placebo-Controlled, Dose Range Finding Study of Danicopan (ALXN2040) in Patients with Geographic Atrophy (GA) Secondary to Age-Related Macular Degeneration (AMD)
Protocol code: ALXN2040-GA-201
Sponsor: Alexion Pharmaceuticals Inc. (Pharmaceutical company). Phase: Therapeutic exploratory (Phase II). Countries: Slovakia (ended), France (ended), Spain (ended), Germany (ended), Hungary (ended), Italy (ended), Czechia (ended), Latvia (ended).
Therapeutic area(s): Diseases [C] - Eye Diseases [C11]
Gender: Female, Male. Age: 18-64 years, 65+ years. Enrolment: 153.
Status: Ended. Start date (EU): 2022-04-29. End date (EU): 2024-10-31. End date: 2025-01-21. Decision date: 2024-05-31. Results received: Yes. Last updated: 2024-06-05.
Decision dates by country: ES: 2024-06-04, CZ: 2024-06-04, FR: 2024-05-31, DE: 2024-05-31, HU: 2024-06-04, IT: 2024-06-05, LV: 2024-05-31, SK: 2024-05-31

Condition(s): Geographic atrophy (GA) secondary to Age-related Macular Degeneration (AMD)
Product: ALXN 2040, Placebo matching ALXN2040

Primary endpoint: Change from Baseline to Week 52 in the square root (sqrt) of total GA lesion area (mm) in the study eye as measured by fundus autofluorescence (FAF)
Endpoint(s): Change from Baseline to Week 104 in the sqrt of the total GA lesion area in the study eye as measured by FAF [Time Frame: Baseline, Week 52 and Week 104], Change from Baseline to Week 52 and Week 104 in the total GA lesion area in the study eye as measured by FAF [Time Frame: Baseline, Week 52 and Week 104], Change from Baseline to Week 52 and Week 104 in macular ellipsoid zone (EZ) and outer retinal integrity in the study eye, the fellow eye, and both eyes combined as measured by SD-OCT, Change from Baseline to Week 52 and Week 104 in subretinal pigment epithelium (sub-RPE) compartment/drusen/RPE complex in the study eye, fellow eye and both eyes combined as measured by SD-OCT., Change from Baseline to Week 52 and Week 104 in monocular Best corrected Visual Acuity (BCVA) scores in the study eye as assessed by the Early Treatment Diabetic Retinopathy Study (ETDRS) chart [Time Frame: Baseline, Week 52 and Week 104], Change from Baseline to Week 52 and Week 104 in monocular Low Luminance Visual Acuity (LLVA) scores in the study eye as assessed by the ETDRS chart [Time Frame: Baseline, Week 52 and Week 104], Change from Baseline to Week 52 and Week 104 in monocular low luminance deficit (BCVA-LLVA) in the study eye [Time Frame: Baseline, Week 52 and Week 104], Change form Baseline to Week 52 and Week 104 in monocular reading speeds in the study eye as assessed by Minnesota Low Vision Reading Test (MNRead) Acuity Charts or Radner Reading Chart [Time Frame: Baseline, Week 52 and Week 104], Change from Baseline to Week 52 and Week 104 in National Eye Institute Visual Function Questionnaire (NEI VFQ-25) scores [Time Frame: Baseline, Week 52 and Week 104], Plasma concentration of Danicopan over time [Time Frame: Up to 4 hours postdose], PD Biomarkers, Ex Vivo Serum Alternative Pathway Activity, and Plasma Bb Concentration Over Time [Time Frame: Up to 4 hours postdose], Incidence of Treatment-emergent Adverse Events (TEAEs), Serious Adverse Events (SAEs), and Ocular TEAEs, SAEs, and clinical laboratory abnormalities, and events leading to discontinuation of study drug throughout the study [Time Frame: Day 1 through Week 104]

Source: https://euclinicaltrials.eu/ctis-public/view/2023-508571-37-00